EU clinical trial 2025-523399-22-00: A Phase 1/2a, Open-Label, Dose-Escalation and Dose-Expansion First-In-Human Study of the Safety, Tolerability, Activity, and Pharmacokinetics of REGN10597 (Anti PD-1-IL2RA-IL2 Fusion Protein) Alone or in Combination with Cemiplimab in Patients with Advanced Solid Organ Malignancies
Protocol code: R10597-ONC-22114
Sponsor: Regeneron Pharmaceuticals Inc. (Pharmaceutical company). Phase: Phase I and Phase II (Integrated)- First administration to humans. Countries: Italy (authorised, recruitment pending), Spain (authorised, recruitment pending), Germany (authorised, recruitment pending), France (authorised, recruitment pending).
Therapeutic area(s): Diseases [C] - Neoplasms [C04]
Gender: Female, Male. Age: 18-64 years, 65+ years. Enrolment: 99.
Status: Authorised, recruitment pending. Decision date: 2026-05-08. Results received: No. Last updated: 2026-06-19.
Decision dates by country: FR: 2026-05-11, IT: 2026-05-11, ES: 2026-05-08, DE: 2026-05-08

Condition(s): Advanced Solid Tumours, Melanoma, Clear-Cell Renal-Cell Carcinoma (ccRCC)
Product: LIBTAYO 350 mg concentrate for solution for infusion., REGN10597, LIBTAYO 350 mg concentrate for solution for infusion., LIBTAYO 350 mg concentrate for solution for infusion., LIBTAYO 350 mg concentrate for solution for infusion.

Primary endpoint: Incidence of Dose-Limiting Toxicities (DLTs), Incidence of Treatment-Emergent Adverse Event (TEAEs), Incidence of Serious Adverse Events (SAEs), Incidence of TEAEs leading to treatment discontinuation, Incidence of TEAEs leading to death, Number of participants with Grade ≥3 laboratory abnormalities, Objective Response Rate (ORR) per Response Evaluation Criteria In Solid Tumors (RECIST 1.1) criteria by investigator assessment
Endpoint(s): ORR based on RECIST 1.1 criteria by investigator assessment, Best Overall Response (BOR) based on RECIST 1.1 criteria, Duration Of Response (DOR) based on RECIST 1.1 criteria, Disease control rate based on RECIST 1.1, Time to response based on RECIST 1.1, Progression Free Survival (PFS) based on RECIST 1.1, Concentrations of REGN10597 in serum, Incidence of Anti-Drug Antibody (ADA) to REGN10597 over time, Magnitude of ADA to REGN10597 over time

Source: https://euclinicaltrials.eu/ctis-public/view/2025-523399-22-00